EU clinical trial 2024-517057-27-00: (MOTOR Study) Neuromuscular MOniTOring in pediatric anesthesia. Randomized clinical study
Protocol code: MOTOR
Sponsor: IRCCS Istituto Giannina Gaslini (Hospital/Clinic/Other health care facility). Phase: Therapeutic confirmatory (Phase III). Countries: Italy (ongoing, recruiting).
Therapeutic area(s): Analytical, Diagnostic and Therapeutic Techniques and Equipment [E] - Anesthesia and Analgesia [E03]
Gender: Female, Male. Age: 0-17 years. Enrolment: 200.
Status: Ongoing, recruiting. Start date (EU): 2026-01-20. Decision date: 2025-06-11. Results received: No. Last updated: 2025-07-21.
Decision dates by country: IT: 2025-07-21

Condition(s): patients scheduled to undergo elective surgical procedures with general anesthesia
Product: Sugammadex 100 mg/ml solution for injection, Rocuronium bromide 10 mg/ml solution for injection/infusion

Primary endpoint: The primary endpoint is the percentage of Sugammadex use in each arm at the end of anesthesia
Endpoint(s): The time needed to extubate patients, the difference in the dose of sugammadex (mg/kg) in the two arms, The frequency of respiratory complications during and after extubation (residual paralysis, upper airway obstruction, laryngospasm, bronchospasm), The best dose needed to reach the reversal of the neuromuscular blockade, indirectly evaluated from the need to administer further doses of sugammadex after extubation, Possible adverse reactions to the use of sugammadex or to the use of TetraGraph System, The incidence of extubation with residual neuromuscular paralysis (TOFr < 0.9), Quality of awakening and occurrence of any episodes of agitation/delirium (Richmond Agitation-Sedation Scale -RASS), The reliability of using quantitative neuromuscular monitoring in pediatrics, in the anesthetist's opinion, The incidence of SpO2 < 90% in the post-operative acute care unit (PACU), The frequency of sugammadex use in patients with TOFr ≥ 0.9

Source: https://euclinicaltrials.eu/ctis-public/view/2024-517057-27-00